EU clinical trial 2024-511560-93-00: An open label, single arm, extension trial to examine long-term safety of Iclepertin once daily in patients with schizophrenia who have completed previous Iclepertin Phase III trials.(CONNEX-X)
Protocol code: 1346-0014
Sponsor: Boehringer Ingelheim International GmbH (Pharmaceutical company). Phase: Therapeutic confirmatory (Phase III). Countries: Netherlands (ended), Croatia (ended), Finland (ended), Portugal (ended), Bulgaria (ended), Belgium (ended), Sweden (ended), Spain (ended), Austria (ended), France (ended), Norway (ended), Italy (ended), Romania (ended), Hungary (ended), Slovakia (ended), Czechia (ended), Denmark (ended), Greece (ended), Germany (ended), Poland (ended), Lithuania (ended).
Therapeutic area(s): Psychiatry and Psychology [F] - Mental Disorders [F03]
Gender: Female, Male. Age: 18-64 years. Enrolment: 396.
Status: Ended. Start date (EU): 2022-03-29. End date (EU): 2025-01-15. End date: 2025-03-18. Decision date: 2024-06-20. Results received: Yes. Last updated: 2024-10-28.
Decision dates by country: AT: 2024-06-25, BG: 2024-06-21, HR: 2024-06-25, DK: 2024-06-20, FR: 2024-07-09, GR: 2024-09-09, HU: 2024-06-20, IT: 2024-06-25, LT: 2024-07-18, PT: 2024-06-20, RO: 2024-06-26, SE: 2024-06-24, NL: 2024-06-20, NO: 2024-06-20, PL: 2024-07-15, SK: 2024-06-20, BE: 2024-06-21, CZ: 2024-06-24, FI: 2024-06-20, DE: 2024-06-21, ES: 2024-06-24

Condition(s): Schizophrenia

Primary endpoint: Occurrence of treatment emergent adverse events (TEAEs) throughout the extension study
Endpoint(s): Change from baseline in Clinical Global Impressions – Severity (CGI-S) to end of treatment (EOT), Change from baseline in Hb to EOT

Source: https://euclinicaltrials.eu/ctis-public/view/2024-511560-93-00